EU clinical trial 2024-515935-31-04: A positron emission tomography study of synaptic nerve cells proteins alpha-7 nicotinic acetylcholine receptors in brain of healthy volunteers and patients with mild cognitive impairment and Alzheimer´s disease.
Protocol code: KIH24001
Sponsor: Karolinska Institutet (Educational Institution). Phase: Human Pharmacology (Phase I)- First administration to humans. Countries: Sweden (authorised, recruiting).
Therapeutic area(s): Diseases [C] - Nervous System Diseases [C10]
Gender: Female, Male. Age: 18-64 years, 65+ years. Enrolment: 45.
Status: Authorised, recruiting. Start date (EU): 2026-02-16. Decision date: 2025-12-05. Results received: No. Last updated: 2026-03-18.

Condition(s): Alzheimer´s disease

Source: https://euclinicaltrials.eu/ctis-public/view/2024-515935-31-04